EU clinical trial 2025-524001-33-00: A Long-Term Extension Study to Assess the Efficacy, Safety, and Tolerability of IMVT-1402 in Adult Patients With Graves' Disease
Protocol code: IMVT-1402-2505
Sponsor: Immunovant Sciences GmbH (Pharmaceutical company). Phase: Therapeutic exploratory (Phase II). Countries: Italy (authorised, recruitment pending), Greece (authorised, recruitment pending), Germany (authorised, recruitment pending), Hungary (authorised, recruitment pending), Poland (ongoing, recruiting), Czechia (ongoing, recruiting), Netherlands (authorised, recruitment pending), Spain (authorised, recruitment pending), Belgium (authorised, recruitment pending), Bulgaria (ongoing, recruiting), Latvia (ongoing, recruiting).
Therapeutic area(s): Diseases [C] - Immune System Diseases [C20]
Gender: Female, Male. Age: 18-64 years, 65+ years. Enrolment: 128.
Start date (EU): 2026-05-22. Decision date: 2026-05-05. Results received: No. Last updated: 2026-08-07.
Decision dates by country: BG: 2026-05-11, DE: 2026-05-11, GR: 2026-05-07, HU: 2026-05-11, LV: 2026-05-06, ES: 2026-05-07, NL: 2026-05-08, PL: 2026-05-08, BE: 2026-05-06, CZ: 2026-05-05, IT: 2026-05-06

Condition(s): Graves’ Disease
Product: IMVT-1402

Primary endpoint: Percentage of Group A Participants who remain euthyroid, off ATD, and off IMVT-1402 [Time Frame: At Week 52]
Endpoint(s): Percentage of Group A Participants who are euthyroid and off ATD [Time Frame: At Week 26], Percentage of Group A Participants who are euthyroid and off ATD [Time Frame: Up to Week 52], Percentage of Group A Participants who are euthyroid, off ATD, and off IMVT-1402 [Time Frame: Up to Week 52], Time to earliest date of euthyroidism, off ATD, and off IMVT-1402 to the earliest date of confirmed relapse in Group A Participants [Time Frame: Up to Week 52], Percentage of Group B Participants who remain euthyroid, off ATD, and off IMVT-1402 [Time Frame: Up to Week 52], Percentage of Group B Participants who remain euthyroid, off ATD, and off IMVT-1402 [Time Frame: At Week 52], Time from Week 0 to the earliest date of confirmed relapse in Group B Participants [Time Frame: Up to Week 52], Percentage of Group C Participants who remain euthyroid, off ATD, and off IMVT-1402 [Time Frame: Up to Week 52], Percentage of Group C Participants who remain euthyroid, off ATD, and off IMVT-1402 [Time Frame: At Week 52], Time From Week 0 to the earliest date of confirmed relapse in Group C Participants [Time Frame: Up to Week 52], Percentage of Group A Participants who are euthyroid, off ATD, and seronegative for TRAb [Time Frame: At Week 26], Percentage of Group A Participants who are euthyroid, off ATD, and seronegative for TRAb [Time Frame: Up to Week 52]

Source: https://euclinicaltrials.eu/ctis-public/view/2025-524001-33-00